EU clinical trial 2022-500933-10-00: Aspirin for the Prevention of Preeclampsia and Pregnancy outcomes in nulliparous women after Assisted Reproductive Technology. APPART trial
Protocol code: RC31/21/0337
Sponsor: Centre Hospitalier Universitaire De Toulouse (Hospital/Clinic/Other health care facility). Phase: Phase III and phase IV (Integrated). Countries: France (ongoing, recruiting).
Therapeutic area(s): Diseases [C] - Pathological Conditions, Signs and Symptoms [C23]; Diseases [C] - Female Urogenital Diseases and Pregnancy Complications [C13]
Gender: Female. Age: 18-64 years. Enrolment: 1164.
Status: Ongoing, recruiting. Start date (EU): 2023-08-02. Decision date: 2022-10-18. Results received: No. Last updated: 2026-05-20.

Condition(s): Preeclampsia during pregnancy
Product: ACETYLSALICYLIC ACID, microcrystalline cellulose with the same size and colour as the active drug

Primary endpoint: Occurrence of preterm (<37 weeks of gestation) preeclampsia (binary variable yes/no).
Endpoint(s): Occurrence of spontaneous and total preterm birth (defined by delivery at <34 weeks of gestation), Occurrence of spontaneous and total preterm birth (defined by delivery at <37weeks of gestation), Occurrence of term (≥37 weeks) preeclampsia., Occurrence of preeclampsia before 34 weeks of gestation., Occurrence of cesarean delivery., Occurrence of postpartum hemorrhage (>500ml), Occurrence of placental abruption, Occurrence of stillbirth, Birthweight, Occurrence of severe maternal morbidity (occurrence of at least one of the following: severe postpartum hemorrhage (>1000ml), treatment of postpartum hemorrhage by embolization, vascular ligature, hysterectomy, secondary post-partum hemorrhage, pulmonary embolism, cardiovascular complications, neuropsychological complications, maternal transfer to intensive care unit, maternal death)., Neonatal death (before 28 days of life) or occurrence of neonatal complications including intraventricular hemorrhage grade II or above, sepsis with confirmed bacteremia in cultures, anemia requiring blood transfusion, respiratory distress syndrome treated with surfactant and ventilation, necrotizing enterocolitis requiring surgery, intensive care unit admission, ventilation with positive airway pressure or intubation., Occurrence of maternal expected adverse events (any bleeding, headache, nausea, skin rash, dyspepsia, abdominal pain) recorded from randomization and until hospital discharge after delivery, Adherence to the treatment (by counting the pills at each visit and by using a diary or an application)., Number of consumed resources and unit costs of hospitalizations, consultations, medical acts, medication, medical devices and transportation., Incremental cost-effectiveness from the collective perspective expressed in terms of cost per number of preterm pre-eclampsia avoided from the initiation of aspirin or placebo 1 months after the delivery., Occupation, level of income and level of education will be recorded to test the impact of socioeconomic characteristics on the cost of care and efficiency.

Source: https://euclinicaltrials.eu/ctis-public/view/2022-500933-10-00